EU clinical trial 2024-517357-27-00: COVID-19 vaccine immunological studies in Finland
Sponsor: Finnish Institute For Health And Welfare (Laboratory/Research/Testing facility). Phase: Therapeutic use (Phase IV). Countries: Finland (ended).
Therapeutic area(s): Diseases [C] - Virus Diseases [C02]
Gender: Female, Male. Age: 18-64 years, 65+ years. Enrolment: 4000.
Status: Ended. Start date (EU): 2021-12-07. End date (EU): 2025-12-17. Decision date: 2024-10-18. Results received: No. Last updated: 2026-02-10.

Condition(s): COVID-19 infection
Product: BIMERVAX LP.8.1 emulsion for injection COVID-19 Vaccine (recombinant, adjuvanted), Spikevax bivalent Original/Omicron BA.1 25 micrograms/25 micrograms dispersion for injection COVID 19 mRNA Vaccine, Comirnaty 30 micrograms/dose dispersion for injection COVID-19 mRNA Vaccine, Spikevax 50 micrograms dispersion for injection in pre-filled syringe COVID-19 mRNA Vaccine, Comirnaty JN.1 30 micrograms/dose dispersion for injection in pre-filled syringe COVID-19 mRNA Vaccine, Nuvaxovid dispersion for injection COVID-19 Vaccine (recombinant, adjuvanted), COVID-19, VIRAL VECTOR, NON-REPLICATING, Comirnaty Original/Omicron BA.4-5 (15/15 micrograms)/dose dispersion for injection COVID-19 mRNA Vaccine, Comirnaty Omicron XBB.1.5 30 micrograms/dose dispersion for injection COVID-19 mRNA Vaccine, Comirnaty LP.8.1 30 micrograms/dose dispersion for injection COVID-19 mRNA Vaccine

Primary endpoint: Proportion of seropositive subjects with an antibody level above the target level in groups of vaccine recipients receiving different vaccine products at 6 months after two doses against the prevailing virus variant
Endpoint(s): Antibody and neutralising antibody levels and percentages of those above the target: in the group receiving combinations of different vaccine products,in a group of people who received the vaccine at different dose intervals (e.g. 3 weeks, 8 weeks, 12 weeks), in the group receiving different numbers of vaccine doses , in the COVID19-infected group, in different age groups, in groups at risk of COVID-19 and in immunocompromised groups, against different virus variants, Cell-mediated immune responses, Response variables regarding immunity studies against other microbes will be developed according to the epidemic situation

Source: https://euclinicaltrials.eu/ctis-public/view/2024-517357-27-00